EU clinical trial 2025-521975-30-00: A Phase 2 Multicohort Trial to Further Characterize the Efficacy and Safety of Ciltacabtagene Autoleucel
Protocol code: 68284528MMY2012
Sponsor: Janssen Cilag International (Pharmaceutical company). Phase: Therapeutic exploratory (Phase II). Countries: Spain (ongoing, recruiting).
Therapeutic area(s): Diseases [C] - Neoplasms [C04]
Gender: Female, Male. Age: 18-64 years, 65+ years. Enrolment: 33.
Status: Ongoing, recruiting. Start date (EU): 2025-10-03. Decision date: 2025-08-20. Results received: No. Last updated: 2026-07-24.

Condition(s): Newly Diagnosed Multiple Myeloma
Product: CARVYKTI 3.2 × 10^6 – 1 × 10^8 cells dispersion for infusion, JNJ-68284528

Primary endpoint: MRD-negative CR at 12 months after cilta-cel infusion with a sensitivity of 10^-5

Source: https://euclinicaltrials.eu/ctis-public/view/2025-521975-30-00